EU clinical trial 2025-521475-31-00: Prestige 2- RimegePant in RElation to obeSiTy in miGainE
Sponsor: Konvent Der Barmherzigen Brueder (Patient organisation/association). Phase: Phase III and phase IV (Integrated). Countries: Austria (ongoing, recruiting).
Therapeutic area(s): Diseases [C] - Nervous System Diseases [C10]
Gender: Female, Male. Age: 18-64 years. Enrolment: 26.
Status: Ongoing, recruiting. Start date (EU): 2026-06-17. Decision date: 2026-03-13. Results received: No. Last updated: 2026-03-13.

Condition(s): Migraine
Product: VYDURA 75 mg oral lyophilisate

Primary endpoint: - Response or non-response to rimegepant 75 mg or 2x75 mg expressed as percentage in pain freedom or freedom from the most bothersome migraine-associated symptom apart from headache after 2 hours (reported in questionnaire)
Endpoint(s): - Freedom from photophobia, phonophobia, nausea and pain relief 2 hours after administration of rimegepant in either 75 mg or 2x75 mg during a moderate to severe migraine episode; probability of using rescue medication within 24 hours after the dose; sustained freedom from pain, sustained pain relief, pain relapse 2 hours to 48 hours after the dose - Blood: sex steroid levels, rimegepant concentration, CGRP. parameters: Total body weight, total body water (TBW), free mass (FFM), fat mass (FM), s

Source: https://euclinicaltrials.eu/ctis-public/view/2025-521475-31-00